EU clinical trial 2022-502221-18-00: Chemoablation or bladder resection with adjuvant chemotherapy in recurrent non-muscle invasive bladder cancer
Sponsor: Aarhus University (Educational Institution). Phase: Therapeutic use (Phase IV). Countries: Denmark (ongoing, recruiting), Norway (ongoing, recruiting), Sweden (ongoing, recruiting), Iceland (authorised, recruitment pending).
Therapeutic area(s): Diseases [C] - Neoplasms [C04]
Gender: Female, Male. Age: 18-64 years, 65+ years. Enrolment: 240.
Start date (EU): 2025-05-26. Decision date: 2024-12-02. Results received: No. Last updated: 2026-04-13.
Decision dates by country: IS: 2024-12-03, DK: 2024-12-03, NO: 2024-12-04, SE: 2024-12-02

Condition(s): Recurrent non-muscle invasive bladder cancer
Product: Mitomycin medac 40 mg powder and solvent for intravesical solution, BCG medac, powder and solvent for intravesical suspension

Primary endpoint: • Two-year RFS. This is defined as event of first recurrence following treatment but not including the recurrence diagnosed at the time of inclusion or persisting tumour following chemoablation.
Endpoint(s): • Five-year RFS, • Number of patients in need of a TURBT or tumour fulguration in the outpatient clinic in the first two years following randomisation, • Number of tumours at first recurrence based on the following intervals: 1, 2-7, > 8, • Number of TURBTs per patient in the first two and five years of follow-up based on the following intervals: 1, 2-5, 5-10 and multiple, • Five-year progression free survival (progression defined as progression to T1-tumour, T2+-tumour, or cystectomy irrespectively of indication), • Five-year overall survival, • Number of patients completing assigned intervention, • Serious adverse events related to MMC treatment during neoadjuvant or adjuvant therapy

Source: https://euclinicaltrials.eu/ctis-public/view/2022-502221-18-00